EU clinical trial 2022-503084-15-00: First in human clinical trial to evaluate the safety, tolerability and preliminary efficacy of the bispecific CD276xCD3 antibody CC-3 in patients with colorectal cancer
Protocol code: CoRe_CC-3
Sponsor: Deutsches Krebsforschungszentrum (DKFZ) (Laboratory/Research/Testing facility). Phase: Human Pharmacology (Phase I)- First administration to humans. Countries: Germany (ongoing, recruiting).
Therapeutic area(s): Diseases [C] - Pathological Conditions, Signs and Symptoms [C23]; Diseases [C] - Digestive System Diseases [C06]
Gender: Female, Male. Age: 18-64 years, 65+ years. Enrolment: 77.
Status: Ongoing, recruiting. Start date (EU): 2024-01-12. Decision date: 2023-11-22. Results received: No. Last updated: 2026-04-30.

Condition(s): Progressive metastatic solid cancer after failure of established treatment options

Source: https://euclinicaltrials.eu/ctis-public/view/2022-503084-15-00